EU clinical trial 2023-503611-16-00: A single arm, open label extension (OLE), multicenter study to evaluate long-term safety and tolerability of pelacarsen (TQJ230) in patients with cardiovascular disease who have successfully completed the Frontiers Apheresis parent study
Protocol code: CTQJ230A12302E1
Sponsor: Novartis Pharma AG (Pharmaceutical company). Phase: Therapeutic confirmatory (Phase III). Countries: Germany (ongoing, recruitment ended).
Therapeutic area(s): Diseases [C] - Cardiovascular Diseases [C14]
Gender: Female, Male. Age: 18-64 years, 65+ years. Enrolment: 60.
Status: Ongoing, recruitment ended. Start date (EU): 2023-09-29. Decision date: 2023-09-13. Results received: No. Last updated: 2026-06-02.

Condition(s): Apheresis
Product: TQJ230

Primary endpoint: Adverse events (AEs) or serious adverse events (SAEs), laboratory evaluations, vital signs and duration of drug exposure
Endpoint(s): Number of lipoprotein apheresis sessions performed yearly for year 1, 2, 3, 4 and 5, Absolute and percentage change in Lp(a) on month 1, month 3, month 6, month 9, month 12, then every 6 months during OLE compared to baseline of the parent study

Source: https://euclinicaltrials.eu/ctis-public/view/2023-503611-16-00